EU clinical trial 2025-521589-83-00: Reassessment of statin-associated musscle symptoms in adults with familial hypercholesterolemia: A phase IV randomized double-blinded n-of-1 crossover trial including periods with atorvastatin, placebo and no study treatment
Protocol code: REMUS
Sponsor: Oslo University Hospital HF (Hospital/Clinic/Other health care facility). Phase: Therapeutic use (Phase IV). Countries: Norway (authorised, recruitment pending).
Therapeutic area(s): Diseases [C] - Cardiovascular Diseases [C14]
Gender: Female, Male. Age: 18-64 years, 65+ years. Enrolment: 70.
Status: Authorised, recruitment pending. Decision date: 2026-05-22. Results received: No. Last updated: 2026-05-22.

Condition(s): Familial hypercholesterolaemia
Product: Encapsulated placebo tablets, Atorvastatin Xiromed 20 mg tablett, filmdrasjert

Primary endpoint: The individual mean difference in muscular symptom intensity over the last two weeks (week 5-6) between treatment periods with atorvastatin and placebo (at least 10 units and 25% difference on a 0-100 units rating scale).
Endpoint(s): Area under the Receiver Operating Characteristic (ROC) curve, and diagnostic sensitivity and specificity.

Source: https://euclinicaltrials.eu/ctis-public/view/2025-521589-83-00